EU clinical trial 2023-510316-39-00: AML-VAC-XS15-01: Multi-peptide vaccination adjuvanted with the TLR1/2 ligand XS15 in acute myeloid leukemia (AML) patients who have achieved complete remission with first line therapy
Sponsor: Universitaetsklinikum Tuebingen AöR (Hospital/Clinic/Other health care facility). Phase: Human Pharmacology (Phase I)- First administration to humans. Countries: Germany (ongoing, recruiting).
Therapeutic area(s): Diseases [C] - Hemic and Lymphatic Diseases [C15]
Gender: Female, Male. Age: 18-64 years, 65+ years. Enrolment: 20.
Status: Ongoing, recruiting. Start date (EU): 2024-06-10. Decision date: 2024-04-18. Results received: No. Last updated: 2026-07-07.

Condition(s): acute myeolic leukemia

Source: https://euclinicaltrials.eu/ctis-public/view/2023-510316-39-00